EU clinical trial 2022-502299-21-00: A Phase 1/2 Study of the CTPS1 Inhibitor STP938 in Adult Subjects with Relapsed/Refractory B Cell and T-Cell Lymphomas
Protocol code: STP938-101
Sponsor: Step Pharma (Pharmaceutical company). Phase: Human Pharmacology (Phase I)- First administration to humans. Countries: France (ongoing, recruiting).
Therapeutic area(s): Diseases [C] - Neoplasms [C04]
Gender: Female, Male. Age: 18-64 years, 65+ years. Enrolment: 85.
Status: Ongoing, recruiting. Start date (EU): 2023-10-18. Decision date: 2023-05-16. Results received: No. Last updated: 2026-06-04.

Condition(s): Relapsed/refractory (R/R) B-cell and T-cell lymphomas

Source: https://euclinicaltrials.eu/ctis-public/view/2022-502299-21-00